EU clinical trial 2023-503802-35-00: A MULTICENTER OPEN LABEL 3 MONTH SAFETY STUDY WITH TRADIPITANT IN PATIENTS WITH IDIOPATHIC OR DIABETIC GASTROPARESIS
Protocol code: VP-VLY-686-3304
Sponsor: Vanda Pharmaceuticals Inc. (Pharmaceutical company). Phase: Therapeutic confirmatory (Phase III). Countries: Belgium (ended), Germany (ended).
Therapeutic area(s): Diseases [C] - Digestive System Diseases [C06]
Gender: Female, Male. Age: 18-64 years, 65+ years. Enrolment: 70.
Status: Ended. Start date (EU): 2023-11-29. End date (EU): 2026-03-30. End date: 2026-03-31. Decision date: 2024-12-03. Results received: No. Last updated: 2026-04-01.
Decision dates by country: DE: 2024-12-03, BE: 2024-12-03

Condition(s): Idiopathic or diabetic gastroparesis with moderate to severe nausea.
Product: Tradipitant

Primary endpoint: To evaluate dosing of tradipitant on standard measures of subject safety by assessing adverse events (AEs) including suicidal ideation or behavior, changes in vital signs, clinical laboratory evaluations, electrocardiograms (ECGs) and physical exam findings during treatment.

Source: https://euclinicaltrials.eu/ctis-public/view/2023-503802-35-00